EU clinical trial 2025-522402-21-00: A first study in humans testing the safety and effects of KUP-101A in patients with certain advanced solid cancers
Protocol code: KUP-CT01
Sponsor: Kupando GmbH (Pharmaceutical company). Phase: Human Pharmacology (Phase I)- First administration to humans. Countries: Germany (ongoing, recruiting).
Therapeutic area(s): Diseases [C] - Neoplasms [C04]
Gender: Female, Male. Age: 18-64 years, 65+ years. Enrolment: 21.
Status: Ongoing, recruiting. Start date (EU): 2026-03-27. Decision date: 2025-11-12. Results received: No. Last updated: 2026-07-02.

Condition(s): Advanced solid tumors (cutaneous melanoma, mucosal melanoma, cutaneous squamous cell carcinoma, Merkel cell carcinoma, or basal cell carcinoma)

Source: https://euclinicaltrials.eu/ctis-public/view/2025-522402-21-00